EU clinical trial 2024-514648-10-00: C0251010 - A PHASE 3, MULTI-CENTER, OPEN-LABEL EXTENSION STUDY TO INVESTIGATE THE LONG-TERM SAFETY, TOLERABILITY, AND EFFICACY OF DAZUKIBART IN PARTICIPANTS WITH IDIOPATHIC INFLAMMATORY MYOPATHIES (INCLUDING PARTICIPANTS WITH DERMATOMYOSITIS OR POLYMYOSITIS)
Protocol code: C0251010
Sponsor: Pfizer Inc. (Pharmaceutical company). Phase: Therapeutic confirmatory (Phase III). Countries: Bulgaria (ongoing, recruiting), Hungary (ongoing, recruiting), Sweden (authorised, recruitment pending), Italy (authorised, recruitment pending), Poland (ongoing, recruiting), Spain (authorised, recruitment pending).
Therapeutic area(s): Diseases [C] - Musculoskeletal Diseases [C05]; Diseases [C] - Immune System Diseases [C20]
Gender: Female, Male. Age: 18-64 years, 65+ years. Enrolment: 23.
Start date (EU): 2025-03-14. Decision date: 2025-01-22. Results received: No. Last updated: 2026-06-01.
Decision dates by country: HU: 2025-01-29, SE: 2025-07-29, IT: 2025-11-14, ES: 2026-06-01, BG: 2025-01-22, PL: 2025-10-26

Condition(s): Idiopathic Inflammatory Myopathy (including dermatomyositis or polymyositis)
Product: METHOTREXATE, Dazukibart, AZATHIOPRINE, HYDROCORTISONE, DEXAMETHASONE, METHYLPREDNISOLONE, CHLOROQUINE PHOSPHATE, MYCOPHENOLATE MOFETIL, BETAMETHASONE, METHYLPREDNISOLONE, PREDNISOLONE, TRIAMCINOLONE ACETONIDE, LEFLUNOMIDE, HYDROXYCHLOROQUINE, DEFLAZACORT, BETAMETHASONE, PREDNISONE, BUDESONIDE, METHOTREXATE

Primary endpoint: TEAEs, SAEs, AESIs, and AEs leading to treatment discontinuation; Clinically significant abnormalities in laboratory tests, ECG measurements, and vital signs; Change from baseline in FVC/DLCO; Absolute values and change from baseline in C-SSRS at all scheduled timepoints.
Endpoint(s): Cohort 1 (DM) and Cohort 2 (PM): • Change from baseline* in MMT-8 score at all scheduled timepoints. • Change from baseline* in PhGA at all scheduled timepoints. • Change from baseline* in extramuscular activity or disease activity score at all scheduled timepoints. • Change from baseline* in results in muscle enzymes at all scheduled timepoints. • Minimal, Moderate, and Major improvement in TIS at all scheduled timepoints. • TIS (continuous) at all scheduled timepoints., Cohort 1 (DM) and Cohort 2 (PM): Change from baseline at all scheduled timepoints in: PROMIS-PF, PtGA, HAQ-DI, FACIT-F, EQ-5D-5L and EQ-VAS, HRU questionnaire; Cohort 1 (DM) only: Change from baseline at all scheduled timepoints in: 5D-Itch Scale, Change from baseline in corticosteroid dose over time; Response over time based on participants achieving: Corticosteroid dose ≤5 mg/day, Corticosteroid free; Change from baseline in non-steroid immunosuppressant/immunomodulator and antimalarial dose over time. Response over time based on participants achieving: Non-steroid immunosuppressants/immunomodulator and antimalarial free., Receive rescue therapy (yes or no) during the study; Number/cycles of rescue therapy received during the study., Auto antibodies (eg. TIF1-γ/P155, NXP2/P140, SAE, JO-1 and MDA-5)., Baseline* and post-treatment ADAs and Nabs., To be continued - secondary endpoint for secondary objective nr.1: Cohort 1 (DM) Only: Percent change from baseline and change from baseline in CDASI-A score at all scheduled timepoints; Change from baseline in CDASI-D score at all scheduled timepoints.

Source: https://euclinicaltrials.eu/ctis-public/view/2024-514648-10-00